EU clinical trial 2024-518044-20-00: T-FORE - Pilot study of a new technique of Oral Fecal Transplantation using frozen stool capsules for the maintenance treatment of pediatric Ulcerative Colitis (UC)
Protocol code: APHP180572
Sponsor: Assistance Publique Hopitaux De Paris (Hospital/Clinic/Other health care facility). Phase: Therapeutic exploratory (Phase II). Countries: France (authorised, recruitment pending).
Therapeutic area(s): Diseases [C] - Digestive System Diseases [C06]
Gender: Female, Male. Age: 0-17 years. Enrolment: 30.
Status: Authorised, recruitment pending. Decision date: 2024-10-14. Results received: No. Last updated: 2025-08-22.

Condition(s): Ulcerative Colitis
Product: Enema transplant of fecal microbiota, Double encapsulated oral transplant of fecal microbiota

Primary endpoint: Success of FMT is defined by an increase in the richness of the recipient's microbiota at 6 months. Microbiota richness will be evaluated by measuring the alpha diversity of the microbiota using Shannon index. The success of the FMT will be defined by an increase in the Shannon index of 0.5 points between the recipient microbiota at M0 and the recipient microbiota at M6.
Endpoint(s): Success of FMT with frozen stool capsules defined by an increase in the richness of the recipient's microbiota at 12 months, will be evaluated by the microbiota alpha diversity using the Shannon index. Success is defined by an increase of 0.5 points between the recipient microbiota at M0 and the recipient microbiota at M12., Success of FMT by stool enema defined by an increase in the richness of the recipient's microbiota at 12 months will be evaluated by the microbiota alpha diversity using the Shannon index. Success is defined by an increase of 0.5 points between the recipient microbiota at M0 and the recipient microbiota at M12., Success of FMT with frozen stool capsules defined by the recipient dysbiotic microbiota being more similar to the healthy donor’s microbiota at 6 and 12 months than the receiver’s before FMT. The success of the FMT is defined by a Bray Curtis (BC) Index [recipient after FMT vs donor] greater than a BC Index [recipient after FMT vs recipient before FMT], with a BC Index [recipient after FMT vs donor] ≥ 0.6, Success of FMT by stool enema defined by the recipient dysbiotic microbiota being more similar to the healthy donor’s microbiota at 6 and 12 months than the receiver’s before FMT. The success of the FMT is defined by a Bray Curtis (BC) Index [recipient after FMT vs donor] greater than a BC Index [recipient after FMT vs recipient before FMT], with a BC Index [recipient after FMT vs donor] ≥ 0.6, Changes on mucosal microbiota at 0 and 12 months. Mucosal microbiota will be studied on biopsies done during colonoscopies at M0 and M12, the microbiota will be studied using the MISeq (RNA 16S). The same success criteria than faecal microbiota at M0 and M12 will be analysed (using Shannon and Bray Curtis indexes, The long term FMT feasibility with frozen stool capsules and by stool enema in children suffering from ulcerative colitis will be evaluated with the number of capsules intake, facility of capsules intake, number of enemas, FMT acceptance, enemas duration, difficulties related to the application of enemas., Ulcerative colitis clinical relapse at 6 and 12 months defined as a Paediatric Ulcerative Colitis Activity Index (PUCAI) > 35, number of relapses during the follow-up, treatments received during the follow-up, Ulcerative colitis Endoscopic relapse at 12 months measured using the Ulcerative Colitis Endoscopic Index of Severity (UCEIS) during the 12 months colonoscopy. Relapse defined as an Ulcerative Colitis Endoscopic Index of Severity (UCEIS) ≥ 2, FMT effect on inflammatory blood markers measured by levels of CRP, VS, leucocytes and faecal calprotein at M0, M6, M9 and M12. Faecal calprotectin dosage will be implemented in the Coprologie Fonctionnelle laboratory of Pr Nathalie Kapel in La Pitié Salpêtrière hospital, Quality of life evolution in both treatment arms evaluated by the IMPACT-3 questionnaire (35 closed questions, Likert scale from 1 to 5 [global ranking: 35 – 175]). Higher score suggests a better quality of life, Adverse events collection : fever, sepsis, infection, inflammatory disease relapse, … etc will be collected for the entire follow up

Source: https://euclinicaltrials.eu/ctis-public/view/2024-518044-20-00